EU clinical trial 2023-508613-17-00: A Randomized, Double-blind, Placebo-controlled Phase 3 study to evaluate Dostarlimab as Sequential Therapy after Chemoradiation in Participants with Locally Advanced Unresected Head and Neck Squamous Cell Carcinoma.
Protocol code: 221530
Sponsor: Glaxosmithkline Research & Development Limited (Pharmaceutical company). Phase: Therapeutic confirmatory (Phase III). Countries: Norway (ongoing, recruiting), Czechia (ongoing, recruiting), Portugal (ongoing, recruiting), Greece (ongoing, recruiting), Spain (ongoing, recruiting), Germany (ongoing, recruitment ended), France (ongoing, recruiting), Belgium (ongoing, recruitment ended), Hungary (ongoing, recruiting), Poland (ongoing, recruiting), Sweden (ongoing, recruiting), Italy (ongoing, recruiting), Romania (ongoing, recruiting).
Therapeutic area(s): Diseases [C] - Neoplasms [C04]
Gender: Female, Male. Age: 18-64 years, 65+ years. Enrolment: 364.
Start date (EU): 2024-05-29. Decision date: 2024-04-29. Results received: No. Last updated: 2026-05-13.
Decision dates by country: IT: 2024-04-30, CZ: 2024-04-30, NO: 2024-04-29, GR: 2024-05-08, BE: 2024-04-29, HU: 2024-05-01, SE: 2024-05-06, PL: 2024-05-06, FR: 2024-04-29, PT: 2024-05-03, RO: 2024-05-08, DE: 2024-05-03, ES: 2024-04-30

Condition(s): Neoplasms, Head and Neck
Product: Locally sourced sterile 0.9% (w/v) sodium chloride, JEMPERLI 500 mg concentrate for solution for infusion

Primary endpoint: Event Free Survival (EFS) where an event is defined as: • First record of locoregional progression or recurrence, or distant metastasis per RECIST 1.1 as per BICR, • Salvage surgery at the primary tumor site when invasive cancer is present, • Neck dissection or surgery performed >20 weeks after completion of CRT when invasive cancer is present, • Death from any cause.
Endpoint(s): OS, defined as time from randomization to death from any cause, Event Free Survival (EFS) where an event is defined as: • First record of locoregional progression or recurrence, or distant metastasis per RECIST 1.1 as per investigator assessment. • Salvage surgery at the primary tumor site when invasive cancer is present. • Neck dissection or surgery performed >20 weeks after completion of CRT when invasive cancer is present. • Death from any cause., Frequency and severity of TEAEs, immune-mediated TEAEs, SAEs TEAE/SAEs leading to dose delays, withdrawal or death. Clinically significant changes in laboratory, vital signs, and safety assessment parameters, Serum concentrations and relevant PK parameters (C-EoI and C trough) for dostarlimab, Incidence of ADA against dostarlimab

Source: https://euclinicaltrials.eu/ctis-public/view/2023-508613-17-00